EU clinical trial 2023-506664-14-00: A randomised, double-blind, multicentre study comparing the efficacy, safety and immunogenicity of proposed Abatacept biosimilar (DRL_AB) with Orencia® administered by the intravenous route as an add-on to methotrexate in the treatment of patients with moderate to severe rheumatoid arthritis
Protocol code: AB-01-004
Sponsor: Dr Reddy's Laboratories Limited (Pharmaceutical company). Phase: Therapeutic confirmatory (Phase III). Countries: Czechia (ended), Hungary (ended), Poland (ended), Bulgaria (ended), Latvia (ended), Lithuania (ended), Estonia (ended), Romania (ended).
Therapeutic area(s): Diseases [C] - Immune System Diseases [C20]
Gender: Female, Male. Age: 18-64 years, 65+ years. Enrolment: 415.
Status: Ended. Start date (EU): 2024-10-24. End date (EU): 2025-12-02. End date: 2025-12-03. Decision date: 2024-04-24. Results received: No. Last updated: 2025-11-11.
Decision dates by country: LT: 2024-04-25, RO: 2024-04-26, CZ: 2024-04-24, BG: 2024-04-26, HU: 2024-04-26, LV: 2024-04-25, EE: 2024-04-29, PL: 2024-04-29

Condition(s): Rheumatoid Arthritis
Product: ORENCIA 250 mg powder for concentrate for solution for infusion, METHOTREXATE/PFIZER, ORENCIA 250 mg powder for concentrate for solution for infusion, ORENCIA 250 mg powder for concentrate for solution for infusion, DRL_AB

Primary endpoint: Primary endpoint for EMA • Change in DAS28-CRP from Baseline to Week 13 [Time Frame: Baseline; Week 13].
Endpoint(s): 1. Change from baseline in DAS28-ESR 2. Change from baseline in DAS28-CRP 3. Proportion of patients with ACR20/50/70 response, 4. Time to EULAR moderate or good response 5. Proportion of patients reaching moderate or good EULAR response based on DAS28-CRP, 6. Incidence of AEs and SAEs 7. Incidences of anaphylactic reactions, hypersensitivity reactions, infections (requiring intravenous antibiotic therapy), infusion related reactions and new malignancies, 8. Incidence of ADAs including NAb and ADA Titres 9. Incidence of ADAs including NAb and ADA Titres during transition phase, 10. Change in PD endpoints (ESR and CRP) from baseline to selected time points till Week 25

Source: https://euclinicaltrials.eu/ctis-public/view/2023-506664-14-00